EU clinical trial 2024-515306-61-00: Comparing short to standard amoxicillin course for eRysipElas: a non-inferiority randomized controlled trial .SHARE II
Protocol code: P150924
Sponsor: Assistance Publique Hopitaux De Paris (Hospital/Clinic/Other health care facility). Phase: Therapeutic use (Phase IV). Countries: France (authorised, recruitment pending).
Therapeutic area(s): Diseases [C] - Bacterial Infections and Mycoses [C01]
Gender: Female, Male. Age: 18-64 years, 65+ years. Enrolment: 656.
Status: Authorised, recruitment pending. Decision date: 2024-11-26. Results received: No. Last updated: 2026-04-24.

Condition(s): Adults diagnosed with lower limbs erysipelas
Product: AMOXICILLIN

Primary endpoint: Rate of complete remission at day 12+/- 2. Complete remission is a composite outcome defined as 1) the disappearance of fever (T°≥ 38°) AND of pain, warmth tenderness erythema and edema at the site of erysipelas and for the cutaneous plaque a clinical severity score less than or equal to 1; and 2) the absence of additional antibiotherapy for cellulitis.
Endpoint(s): Rate of clinical remission: the disappearance of fever (T°≥38°) AND of pain, warmth tenderness erythema and edema at the site of erysipelas and for the cutaneous plaque a clinical severity score less than or equal to 1 at day 12+/- 2., Rate and number of patients not receiving additional antibiotherapy at day 12+/- 2, Rate of recurrence is defined by the need for additional antibiotic therapy for cellulitis between day 12 and day 28+/- 2., Rate of adverse event during the treatment and the follow up periods as reported by the patient., Rate of clinical remission: the disappearance of fever (T°≥38°) AND of pain, warmth tenderness erythema and edema at the site of erysipelas and for the cutaneous plaque a clinical severity score less than or equal to 1, without receiving additional antibiotherapy at day 7 +/- 2

Source: https://euclinicaltrials.eu/ctis-public/view/2024-515306-61-00